EU clinical trial 2024-519529-40-00: “USE OF A FIBRIN ADHESIVE TO REDUCE ESOPHAGOYEJUNAL ANASTOMOSIS DEHISCENCE IN TOTAL GASTRECTOMIES FOR CANCER: RANDOMIZED AND MULTICENTER STUDY”
Sponsor: Hospital Germans Trias I Pujol (Hospital/Clinic/Other health care facility). Phase: Therapeutic confirmatory (Phase III). Countries: Spain (authorised, recruitment pending).
Therapeutic area(s): Not possible to specify
Gender: Female, Male. Age: 18-64 years, 65+ years. Enrolment: 240.
Status: Authorised, recruitment pending. Decision date: 2025-01-15. Results received: No. Last updated: 2025-01-15.

Condition(s): ESOPHAGOYEJUNAL ANASTOMOSIS DEHISCENCE IN TOTAL GASTRECTOMIES FOR CANCER
Product: TISSEEL Soluciones para adhesivo tisular

Primary endpoint: Suture dehiscence diagnosed within the first seven days after surgery, using clinical and/or radiological parameters. Csendes classification
Endpoint(s): Type of anastomosis performed: manual, mechanical (circular or linear), Amylases in drainage on days 1,3,5,7 postoperatively or until the drainage is removed., Leukocytes, procalcitonin, C-reactive protein in blood on days 0,1,3,5,7 postoperatively., Day of CT with oral contrast. CT findings according to Goense score, Postoperative complication and type (Clavien Dindo Classification), Need for urgent surgical reintervention, In-hospital and 90-day mortality, Date of hospital discharge, Readmissions at 30 and 90 days

Source: https://euclinicaltrials.eu/ctis-public/view/2024-519529-40-00